EU clinical trial 2023-507910-28-00: Safety, tolerability, pharmacokinetics and pharmacodynamics of ARV-102 in healthy participants
Protocol code: ARV-102-101
Sponsor: Arvinas Operations Inc. (Pharmaceutical company). Phase: Human Pharmacology (Phase I)- First administration to humans. Countries: Netherlands (ended).
Therapeutic area(s): Phenomena and Processes [G] - Musculoskeletal and Neural Physiological Phenomena [G11]
Gender: Male. Age: 18-64 years. Enrolment: 96.
Status: Ended. Start date (EU): 2024-01-04. End date (EU): 2025-02-13. Decision date: 2023-12-21. Results received: No. Last updated: 2024-07-19.

Condition(s): Parkinson's Disease

Source: https://euclinicaltrials.eu/ctis-public/view/2023-507910-28-00